EU clinical trial 2024-516687-28-00: SATELITE - Salvage Therapy for Patients with Inadequate Response to Standard of Care Therapy in Granulomatosis with Polyangiitis
Protocol code: APHP200026
Sponsor: Assistance Publique Hopitaux De Paris (Hospital/Clinic/Other health care facility). Phase: Therapeutic confirmatory (Phase III). Countries: France (temporarily halted).
Therapeutic area(s): Diseases [C] - Hemic and Lymphatic Diseases [C15]
Gender: Female, Male. Age: 18-64 years. Enrolment: 42.
Status: Temporarily halted. Start date (EU): 2025-06-06. Decision date: 2024-11-19. Results received: No. Last updated: 2026-02-06.

Condition(s): Patients with GPA and inadequate response to standard of care therapy defined as an inadequate response to either a combination of glucocorticoids plus cyclophosphamide AND/OR a combination of glucocorticoids plus rituximab.
Product: RITUXIMAB, METHOTREXATE, MYCOPHENOLATE MOFETIL, RoActemra 162 mg solution for injection in pre-filled pen., AZATHIOPRINE, XELJANZ 5 mg film-coated tablets

Primary endpoint: The primary endpoint will be the proportion of patients with a response or a remission at 12 weeks as defined according to the EULAR recommendations. Remission is defined as the absence of disease activity attributable to active disease qualified by the need for ongoing stable maintenance immunosuppressive therapy. The term ‘‘active disease’’ is not restricted to vasculitis only, but also includes other inflammatory features like granulomatous inflammation. Response is defined as a 50% reduction
Endpoint(s): Secondary endpoints: - The proportion of patients with a response or a remission according to the EULAR recommendations at week 24 and 52. - The difference between the physician’s and patient’s global assessment of disease activity between baseline and week 12 and between baseline and week 52. - The patient-reported outcomes (PRO) including: HAQ, SF-36 and VAA-PRO at week 12, 24 and 52-The number of adverse events, expressed as adverse events according to the CTCAE toxicity grading system pe

Source: https://euclinicaltrials.eu/ctis-public/view/2024-516687-28-00